EU clinical trial 2023-507902-15-00: Phase 2, Open-Label Safety and Efficacy Study of Telisotuzumab Vedotin (ABBV-399) in Subjects with Previously Treated c-Met+ Non-Small Cell Lung Cancer
Protocol code: M14-239
Sponsor: AbbVie Deutschland GmbH & Co. KG (Pharmaceutical company). Phase: Therapeutic exploratory (Phase II). Countries: Ireland (ended), Spain (ongoing, recruitment ended), France (ended), Romania (ongoing, recruitment ended), Belgium (ongoing, recruitment ended), Germany (ended), Italy (ended), Greece (ended).
Therapeutic area(s): Diseases [C] - Neoplasms [C04]
Gender: Female, Male. Age: 18-64 years, 65+ years. Enrolment: 67.
Start date (EU): 2019-03-26. Decision date: 2023-12-01. Results received: No. Last updated: 2026-04-22.
Decision dates by country: IE: 2023-12-01, RO: 2023-12-05, IT: 2023-12-21, FR: 2023-12-06, DE: 2023-12-15, BE: 2023-12-08, ES: 2023-12-01, GR: 2024-03-04

Condition(s): Non-Small Cell Lung Cancer
Product: Telisotuzumab Vedotin

Primary endpoint: Overall Response Rate (ORR)
Endpoint(s): Duration of Response (DoR), Disease Control Rate (DCR), Progression-Free Survival (PFS), Overall Survival (OS)

Source: https://euclinicaltrials.eu/ctis-public/view/2023-507902-15-00